EU clinical trial 2024-514866-37-01: Cell-based immunotherapy in solid organ transplantation to minimize systemic immunosuppression
Protocol code: 1311
Sponsor: Karolinska University Hospital (Hospital/Clinic/Other health care facility). Phase: Phase I and Phase II (Integrated)- Bioequivalence Study. Countries: Sweden (authorised, recruitment pending).
Therapeutic area(s): Diseases [C] - Digestive System Diseases [C06]
Gender: Female, Male. Age: 18-64 years, 65+ years. Enrolment: 18.
Status: Authorised, recruitment pending. Decision date: 2024-10-17. Results received: No. Last updated: 2024-10-17.

Condition(s): Patients with end-stage liver disease undergoing liver transplantation with deceased donor organ
Product: Donor specific immunomodulatory cells (DSIMC)

Primary endpoint: Safety evaluation of the protocol at 12 months after deceased donor liver transplantation.
Endpoint(s): Percentage of patients that are completely weaned of immunosuppression at 36 months after liver transplantation with preserved optimal liver function, and level of immunosuppression used in patients not completely weaned from immunosuppression at the same time point

Source: https://euclinicaltrials.eu/ctis-public/view/2024-514866-37-01